EU clinical trial 2024-519381-53-00: A study to find out how healthy people tolerate a new drug called S221237.
Protocol code: CL1-221237-002
Sponsor: Institut De Recherches Internationales Servier IRIS (Pharmaceutical company). Phase: Human Pharmacology (Phase I)- First administration to humans. Countries: France (ended).
Therapeutic area(s): Diseases [C] - Nervous System Diseases [C10]
Gender: Female, Male. Age: 18-64 years, 65+ years. Enrolment: 103.
Status: Ended. Start date (EU): 2022-10-04. End date (EU): 2024-10-14. Decision date: 2024-11-13. Results received: No. Last updated: 2024-11-13.

Condition(s): Parkinson disease (PD)

Source: https://euclinicaltrials.eu/ctis-public/view/2024-519381-53-00